EU clinical trial 2025-521906-16-00: Evaluation of the efficacy and safety of drug treatment in familial polycythemia associated with an EPO gene mutation: a multicentre, open-label, phase I trial
Protocol code: ESPOiR
Sponsor: Centre Hospitalier Universitaire De Dijon (Hospital/Clinic/Other health care facility). Phase: Human Pharmacology (Phase I)- Other. Countries: France (ongoing, recruitment ended).
Therapeutic area(s): Diseases [C] - Hemic and Lymphatic Diseases [C15]
Gender: Female, Male. Age: 18-64 years, 65+ years. Enrolment: 4.
Status: Ongoing, recruitment ended. Start date (EU): 2025-08-01. Decision date: 2025-07-08. Results received: No. Last updated: 2026-07-24.

Condition(s): familial polycythemia associated with an EPO gene mutation

Source: https://euclinicaltrials.eu/ctis-public/view/2025-521906-16-00